EU clinical trial 2024-513167-68-00: A Randomized, Double-Blind, Phase 3 Trial of Maintenance with Selinexor/ Placebo After Combination Chemotherapy for Patients with Advanced or Recurrent Endometrial Cancer
Sponsor: Karyopharm Therapeutics Inc. (Pharmaceutical company). Phase: Therapeutic confirmatory (Phase III). Countries: Italy (ended), Germany (ended), Belgium (ended), Greece (ended), Czechia (ended), Spain (ended).
Therapeutic area(s): Diseases [C] - Neoplasms [C04]
Gender: Female. Age: 18-64 years, 65+ years. Enrolment: 70.
Status: Ended. Start date (EU): 2017-11-29. End date (EU): 2025-03-27. End date: 2025-04-03. Decision date: 2024-10-15. Results received: Yes. Last updated: 2025-05-23.
Decision dates by country: ES: 2024-10-15, BE: 2024-10-15, CZ: 2024-10-18, DE: 2024-10-23, GR: 2024-10-24, IT: 2024-10-21

Condition(s): endometrial cancer
Product: SELINEXOR, Selinexor placebo for 20 mg tablets is formulated for oral administration. selinexor placebo tablets are film coated bi-convex round tablets

Primary endpoint: The primary endpoint for this study is Progression Free Survival (PFS), which is defined as the time from randomization until documented PD or death due to any cause, whichever occurs first. For the primary analysis of the primary endpoint, documented PD will be determined by the Investigator using RECIST v1.1.
Endpoint(s): PFS, as assessed by a BICR, per RECIST v1.1, Time to first subsequent therapy (TFST) and time to second subsequent treatment (TSST)., Progression-free survival (PFS2), Disease-specific survival (DSS) and overall survival (OS), Disease-control rate (DCR; defined as best response of CR, PR, or SD for at least 16 weeks)., European Organisation for Research and Treatment of Cancer [EORTC] Quality of Life Questionnaire (QLQ)-C30 and EORTC QLQ-EN24., The safety and tolerability of study treatment will be evaluated based on AE reports, physical examination results (including vital signs), and clinical laboratory results by means of the occurrence, nature and severity of AEs.

Source: https://euclinicaltrials.eu/ctis-public/view/2024-513167-68-00